EU clinical trial 2025-523269-31-00: SIE-1
Protocol code: ROV-SIE-2025-01
Sponsor: Laboratorios Farmaceuticos Rovi S.A. (Pharmaceutical company). Phase: Human Pharmacology (Phase I)- Other. Countries: Spain (ongoing, recruiting).
Therapeutic area(s): Diseases [C] - Neoplasms [C04]
Gender: Female. Age: 18-64 years, 65+ years. Enrolment: 57.
Status: Ongoing, recruiting. Start date (EU): 2026-06-02. Decision date: 2026-03-31. Results received: No. Last updated: 2026-05-19.
Decision dates by country: ES: 2026-05-19

Condition(s): Hormone receptor-positive early breast cancer in post-menopausal women

Source: https://euclinicaltrials.eu/ctis-public/view/2025-523269-31-00